EU clinical trial 2024-515864-30-00: Study 1002-041: An Open-Label Study to Evaluate the Pharmacokinetics, Pharmacodynamics, and Safety of Bempedoic Acid in Pediatric Patients (6 to 17 Years of Age) with Heterozygous Familial Hypercholesterolemia
Protocol code: 1002-041
Sponsor: Esperion Therapeutics Inc. (Pharmaceutical company). Phase: Therapeutic exploratory (Phase II). Countries: Germany (ended), Netherlands (ended), Denmark (ended), Spain (ended).
Therapeutic area(s): Diseases [C] - Cardiovascular Diseases [C14]
Gender: Female, Male. Age: 0-17 years. Enrolment: 27.
Status: Ended. Start date (EU): 2025-03-12. End date (EU): 2025-03-14. End date: 2025-06-04. Decision date: 2024-09-23. Results received: Yes. Last updated: 2025-03-03.
Decision dates by country: DK: 2024-09-27, ES: 2024-10-02, DE: 2024-09-25, NL: 2024-09-23

Condition(s): Heterozygous familial hypercholesterolemia, Heterozygous Familial Hypercholesterolemia
Product: Bempedoic acid, bempedoic acid

Primary endpoint: Observed trough plasma concentration of ETC-1002 following 8 weeks of steady-state dosing of bempedoic acid, Model-based PK parameters including steady-state estimates of: −area under the plasma concentration-time curve (AUCss), −average plasma concentration (Cavg,ss) and −maximum plasma concentration (Cmax,ss)
Endpoint(s): Observed trough plasma concentration of ESP15228 (active metabolite) following 8 weeks of steady-state dosing of bempedoic acid, Plasma concentration at 4 hours (C4hr) of ETC-1002 and ESP15228 following first dose, ETC-1002 dose and exposure/LDL-C-lowering response relationship, Percent and absolute from baseline to Weeks 8 and 16 in LDL-C, TC, non-HDL-C, and hsCRP, Evaluation of acceptability (taste and ease of swallowing) of the age appropriate formulations

Source: https://euclinicaltrials.eu/ctis-public/view/2024-515864-30-00